EU clinical trial 2025-523743-35-00: Comparative Study on the Mode of Action of Vicadrostat and Spironolactone on Protein Profiles and Renal Hemodynamic Effects in Patients with Heart Failure or Cardiovascular Disease and Chronic Kidney Disease (COMPARE-VS)
Protocol code: COMPARE-VS
Sponsor: Universitair Medisch Centrum Groningen (Hospital/Clinic/Other health care facility). Phase: Therapeutic exploratory (Phase II). Countries: Netherlands (ongoing, recruiting).
Therapeutic area(s): Diseases [C] - Cardiovascular Diseases [C14]
Gender: Female, Male. Age: 18-64 years, 65+ years. Enrolment: 100.
Status: Ongoing, recruiting. Start date (EU): 2026-04-07. Decision date: 2026-03-23. Results received: No. Last updated: 2026-03-23.

Condition(s): Heart failure, cardiovascular disease, chronic kidney disease
Product: Jardiance 10 mg film-coated tablets, BI 690517, Spironolacton Accord 25 mg filmomhulde tabletten, OMNIPAQUE 350 mg I/ml., AMINOHIPPURIC ACID

Primary endpoint: The primary endpoint for kidney function is the change in eGFR baseline to 4 and 26 weeks of treatment
Endpoint(s): The endpoints for the renal hemodynamic changes includes measured glomerular filtration rate (mGFR), effective renal plasma flow (ERPF), renal blood flow (RBF), renal vascular resistance (RVR), glomerular pressure (Pglo), afferent vascular resistance (Ra) and efferent vascular resistance (Re) at baseline and after 4 and 26 weeks of treatment, Endpoints related to plasma and urinary protein profiles are the difference in changes in their profiles between vicadrostat and spironolactone after 4 and 26 weeks of treatment, Changes in UACR and urinary concentration of sodium, NGAL, and KIM-1 from baseline to 4 and 26 weeks

Source: https://euclinicaltrials.eu/ctis-public/view/2025-523743-35-00